EU clinical trial 2023-503770-21-00: A Randomized, Double-Blind, Placebo-Controlled, Dose-Ranging Study to Evaluate the Efficacy and Safety of SPR001 (Tildacerfont) in Adult Subjects with Classic Congenital Adrenal Hyperplasia
Protocol code: SPR001-203
Sponsor: Spruce Biosciences Inc. (Pharmaceutical company). Phase: Therapeutic exploratory (Phase II). Countries: Sweden (ended), Netherlands (ended), Ireland (ended), Italy (ended), Romania (ended), Estonia (ended), Denmark (ended), Latvia (ended), Lithuania (ended), Spain (ended), Germany (ended), Poland (ended).
Therapeutic area(s): Phenomena and Processes [G] - Genetic Phenomena [G05]
Gender: Female, Male. Age: 18-64 years, 65+ years. Enrolment: 26.
Status: Ended. Start date (EU): 2021-01-05. End date (EU): 2024-03-24. End date: 2024-03-24. Decision date: 2023-04-25. Results received: Yes. Last updated: 2024-03-29.
Decision dates by country: LT: 2023-05-25, IE: 2023-05-16, DE: 2023-05-02, EE: 2023-05-01, SE: 2023-04-26, PL: 2023-06-06, LV: 2023-05-17, RO: 2023-05-09, NL: 2023-05-01, ES: 2023-05-30, DK: 2023-04-25, IT: 2023-05-29

Condition(s): Classic Congenital Adrenal Hyperplasia
Product: Hydrocortisone, same as IMP (Tildacerfont) minus active substance, Tildacerfont

Primary endpoint: Percent change from baseline in androstenedione after 12 weeks on treatment (Week 18).
Endpoint(s): 1. Proportion of subjects who achieve androstenedione ≤ upper limit of normal after 12 weeks on treatment (Week 18), 2. Proportion of subjects who achieve 17-hydroxyprogesterone ≤ 1200 ng/dL after 12 weeks on treatment (Week 18)., 3. Change in the lesion volume of testicular adrenal rest tumor(s) from baseline after 12 weeks on treatment (Week 18)

Source: https://euclinicaltrials.eu/ctis-public/view/2023-503770-21-00